EU clinical trial 2023-508389-13-00: Renal Lifecycle Trial: A Randomized Controlled Clinical Trial to Assess the Effect of Dapagliflozin on Renal and Cardiovascular Outcomes in Patients with Severe Chronic Kidney Disease
Protocol code: 202100617
Sponsor: Universitair Medisch Centrum Groningen (Hospital/Clinic/Other health care facility). Phase: Therapeutic confirmatory (Phase III). Countries: Netherlands (ongoing, recruiting), Germany (ongoing, recruiting), Belgium (ongoing, recruiting), Spain (ongoing, recruiting).
Therapeutic area(s): Diseases [C] - Cardiovascular Diseases [C14]
Gender: Female, Male. Age: 18-64 years, 65+ years. Enrolment: 1560.
Status: Ongoing, recruiting. Start date (EU): 2022-11-08. Decision date: 2024-02-07. Results received: No. Last updated: 2026-08-07.
Decision dates by country: BE: 2024-10-22, NL: 2024-02-07, ES: 2025-03-21, DE: 2024-02-16

Condition(s): Combined endpoint of all-cause mortality, kidney failure, and hospitalization for heart failure in the overall study population
Product: Placebo for dapagliflozin film-coated tablets 10 mg, DAPAGLIFLOZIN

Primary endpoint: Time to the composite endpoint of all-cause mortality, kidney failure (chronic dialysis, kidney transplantation or death due to kidney failure), and hospitalization for heart failure
Endpoint(s): Time to kidney failure (in advanced CKD and transplant patients only), Time to the first occurrence of heart failure hospitalization, Time to all-cause death, In addition, it will be investigated whether dapagliflozin is superior to placebo in reducing the incidence of the composite outcome of all-cause mortality, kidney failure, or heart failure hospitalization in each of the three subpopulations.

Source: https://euclinicaltrials.eu/ctis-public/view/2023-508389-13-00